EU clinical trial 2023-508472-11-00: A Randomized, Double-Blind, Phase III Clinical Trial of Neoadjuvant Chemotherapy with Atezolizumab or Placebo in Patients with Triple-Negative Breast Cancer Followed by Adjuvant Continuation of Atezolizumab or Placebo "GeparDouze"
Protocol code: NSABP B-59/GBG 96
Sponsor: NSABP Foundation Inc. (Laboratory/Research/Testing facility). Phase: Therapeutic confirmatory (Phase III). Countries: Germany (ended), Spain (ended).
Therapeutic area(s): Diseases [C] - Neoplasms [C04]
Gender: Female, Male. Age: 18-64 years, 65+ years. Enrolment: 978.
Status: Ended. Start date (EU): 2018-06-13. End date (EU): 2025-11-19. Decision date: 2023-12-11. Results received: No. Last updated: 2025-08-05.
Decision dates by country: DE: 2023-12-12, ES: 2023-12-11

Condition(s): Patients with early breast cancer
Product: FARMORUBICIN® 50 mg HL Pulver zur Herstellung einer Injektionslösung, DOXO-cell 150 mg Injektionslösung, DOXO-cell 10 mg Injektionslösung, Endoxan, Endoxan 100 mg, Endoxan, Paclitaxel onkovis, 6 mg/ml, Konzentrat zur Herstellung einer Infusionslösung, DOXO-cell 50 mg Injektionslösung, Endoxan, Endoxan®, Placebo number: pl1; pharmaceutical form: sterile concentrate; route of administration: intravenous use, Tecentriq, Carboplatin onkovis 10 mg/ml Infusionslösung

Primary endpoint: EFS is defined as time from randomization until event: EFS events are progression on protocol therapy resulting in administration of non-protocol cancer therapy or inoperability, local invasive recurrence following mastectomy, local invasive recurrence in the ipsilateral breast following lumpectomy, regional recurrence, distant recurrence, contralateral invasive breast cancer, second non-breast primary cancer, or death from any cause prior to recurrence or second primary cancer
Endpoint(s): Defined as time from randomization until death from any cause., Defined as the absence of any invasive component in the resected breast specimen and all resected lymph nodes following completion of neoadjuvant therapy (ypT0/Tis ypN0)., Defined as time from the first breast surgical procedure to the first occurrence of disease recurrence or death from any cause. Events defining DFS are ipsilateral invasive breast tumor recurrence, ipsilateral local-regional invasive breast cancer recurrence, distant recurrence, contralateral invasive breast cancer, ipsilateral or contralateral DCIS, second primary non-breast invasive cancer and death attributable to any cause including breast cancer, non-breast cancer, or unknown cause., Defined as time from randomization until distant recurrence, death from breast cancer, death from other causes, and second primary invasive cancer (non-breast)., Frequency and severity of adverse events graded according to the NCI Common Terminology Criteria for Adverse Events version 4.0 (CTCAE v4.0)., Troponin-T levels 1) prior to initial dose of AC/EC following completion of carboplatin/paclitaxel co-administered with atezolizumab/placebo and after administration of the 1st and 3rd cycles of AC/EC prior to administration of atezolizumab/placebo. LVEF levels at 1) baseline prior to initiation of carboplatin/paclitaxel and atezolizumab/placebo, 2) before 3rd cycle of AC/EC, and 3) after surgery.

Source: https://euclinicaltrials.eu/ctis-public/view/2023-508472-11-00